EU clinical trial 2022-502317-29-00: A Phase II, Open-Label, Multi-Drug, Multi-Center, Master Protocol to Evaluate the Efficacy and Safety of Novel Immunomodulators as Monotherapy and in Combination with Anticancer Agents in Participants with Advanced Hepatobiliary Cancer (GEMINI-Hepatobiliary)
Protocol code: D7987C00001
Sponsor: AstraZeneca AB (Pharmaceutical company). Phase: Therapeutic exploratory (Phase II). Countries: Spain (ongoing, recruitment ended), Italy (ongoing, recruitment ended).
Therapeutic area(s): Diseases [C] - Neoplasms [C04]
Gender: Female, Male. Age: 18-64 years, 65+ years. Enrolment: 60.
Status: Ongoing, recruitment ended. Start date (EU): 2023-07-12. Decision date: 2023-05-30. Results received: No. Last updated: 2026-05-06.
Decision dates by country: ES: 2025-04-03, IT: 2023-05-30

Condition(s): Advanced Hepatobiliary Cancer
Product: Gemcitabina Accord 100 mg/ml concentrato per soluzione per infusione., Gemsol 40 mg/ml concentrato per soluzione per infusione, Remsima 120 mg solution for injection in pre-filled pen, Cisplatino Accord Healthcare Italia 1 mg/ml concentrato per soluzione per infusione, Mycophenolate Mofetil 500 mg film-coated tablets, Rilvegostomig, Avastin 25 mg/ml concentrate for solution for infusion, Gemcitabin HEXAL® 40 mg/ml Konzentrat zur Herstellung einer Infusionslösung, Cisplatin NeoCorp 1 mg/ml - Konzentrat zur Herstellung einer Infusionslösung, LENVIMA 4 mg hard capsules, volrustomig, Cisplatino Sandoz 0,5 mg/ml – Concentrato per soluzione per infusione, Gemcitabina Accord 100 mg/ml concentrato per soluzione per infusione., Cisplatino Accord Healthcare Italia 1 mg/ml concentrato per soluzione per infusione

Primary endpoint: ORR for sub-study 1 and PFS for sub-study 2 determined by the Investigator at local site per RECIST 1.1., Incidence of AEs, AESIs, SAEs, and AEs leading to discontinuation of treatment
Endpoint(s): Duration Of Response (DOR) per RECIST 1.1 based on Investigator assessment, Disease Control Rate (DCR) at 12 and 24 weeks per RECIST 1.1 as assessed by the Investigator, Progression free survival (PFS) per RECIST 1.1 based on Investigator assessment, Overall Survival (OS), Serum concentrations of novel immunomodulators and derived PK parameters, Incidences of ADAs against novel immunomodulators in serum

Source: https://euclinicaltrials.eu/ctis-public/view/2022-502317-29-00